EU clinical trial 2023-506686-66-01: IDE196 (Darovasertib) in Combination with Crizotinib Versus Investigator’s Choice of Treatment as First-line Therapy in HLA-A2 Negative Metastatic Uveal Melanoma
Protocol code: IDE196-002
Sponsor: Ideaya Biosciences Inc. (Pharmaceutical company). Phase: Phase II and Phase III (Integrated). Countries: Spain (ongoing, recruitment ended), Italy (ongoing, recruitment ended), Poland (ongoing, recruitment ended), Germany (ongoing, recruitment ended), Belgium (ongoing, recruitment ended), France (ongoing, recruitment ended), Netherlands (ongoing, recruitment ended).
Therapeutic area(s): Phenomena and Processes [G] - Ocular Physiological Phenomena [G14]; Diseases [C] - Neoplasms [C04]; Diseases [C] - Eye Diseases [C11]
Gender: Female, Male. Age: 18-64 years, 65+ years. Enrolment: 154.
Status: Ongoing, recruitment ended. Start date (EU): 2024-10-09. Decision date: 2024-08-09. Results received: No. Last updated: 2026-01-26.
Decision dates by country: PL: 2024-08-12, NL: 2024-08-12, BE: 2024-08-09, ES: 2024-08-09, DE: 2024-08-12, IT: 2024-08-13, FR: 2024-09-13

Condition(s): HLA-A2 negative metastatic uveal melanoma
Product: DACARBAZINE, IPILIMUMAB, IDE196 (LXS196), NIVOLUMAB, CRIZOTINIB, CRIZOTINIB, PEMBROLIZUMAB, IDE196 (LXS196)

Primary endpoint: Dose-exposure-response (S&E) relationship; Plasma concentration profiles and PK parameters ;TEAEs, laboratory test abnormalities, ECG and vital sign changes; Study intervention discontinuation due to AEs; PFS, defined as the time from randomization to the first documented date of disease progression or death due to any cause, whichever occurs first; OS (time from randomization to date of death due to any cause
Endpoint(s): ORR, defined as the proportion of participants with a complete response (CR) or a partial response (PR) as best objective response (BOR), • PFS • ORR, • TEAEs, laboratory test abnormalities, ECG, and vital sign changes. • Study treatment discontinuation due to AEs, • BOR • Disease control rate (DCR), defined as CR or PR, or stable disease (SD) ≥ 12 weeks • DOR, defined as the time from the first documented evidence of a CR or PR until disease progression or death due to the underlying disease, whichever occurs first • Time to response, • PFS, • BOR • ORR • DCR • DOR • Time to response, • Change from baseline over time and between treatment arms in European Organisation for Research and Treatment of Cancer (EORTC) QLQ-C30 and EuroQoL (EQ)-5D- 5L scores

Source: https://euclinicaltrials.eu/ctis-public/view/2023-506686-66-01